EU clinical trial 2025-521513-14-00: A Phase 2, Single-Arm Study of INCB123667 in Participants With Platinum-Resistant Ovarian Cancer With Cyclin E1 Overexpression “(MAESTRA 1)”
Protocol code: INCB123667-203
Sponsor: Incyte Corp. (Pharmaceutical company). Phase: Therapeutic exploratory (Phase II). Countries: Spain (ongoing, recruiting), Belgium (ongoing, recruiting).
Therapeutic area(s): Diseases [C] - Neoplasms [C04]
Gender: Female. Age: 18-64 years, 65+ years. Enrolment: 29.
Status: Ongoing, recruiting. Start date (EU): 2026-02-10. Decision date: 2025-12-12. Results received: No. Last updated: 2026-07-10.
Decision dates by country: ES: 2025-12-12, BE: 2025-12-17

Condition(s): Ovarian Cancer

Primary endpoint: Objective response by IRC, defined as having a confirmed best overall response of CR or PR, as determined by IRC assessment per RECIST v1.1.
Endpoint(s): 1. DOR by IRC, defined as the time from the earliest date of CR or PR contributing to a subsequently confirmed CR or PR until the earliest date of disease progression, as determined by IRC assessment per RECIST v1.1, or death due to any cause, whichever occurs first., 2. PFS by IRC, defined as the time from the date of first dose of study drug until the earliest date of disease progression as determined by IRC assessment per RECIST v1.1, or death due to any cause, whichever occurs first., 3. OS, defined as the time from the date of first dose of study drug until death due to any cause., 4. Objective response by investigator, defined as having a confirmed best overall response of CR or PR, as determined by investigator assessment per RECIST v1.1., 5. DOR by investigator, defined as the time from the earliest date of CR or PR contributing to a subsequently confirmed CR or PR until the earliest date of disease progression, as determined by investigator assessment per RECIST v1.1, or death due to any cause, whichever occurs first., 6. PFS by investigator, defined as the time from the date of first dose of study drug until the earliest date of disease progression, as determined by investigator assessment per RECIST v1.1, or death due to any cause, whichever occurs first., 7. AEs, assessed by physical examinations, evaluating changes in vital signs and ECGs, and through clinical laboratory blood sample evaluations., 8. Impact on study treatment, assessed by treatment interruptions, dose reductions, and discontinuation of study treatment due to AEs.

Source: https://euclinicaltrials.eu/ctis-public/view/2025-521513-14-00